EU clinical trial 2024-515342-16-00: Improving the empowerment in patients with severe breast fibrosis radio-induced treated by Pravastatin : benefit of e-PROs (electronic « Patient Reported Outcome ») on breast-related quality of life
Protocol code: PROICM 2019-02 PRA
Sponsor: Institut Regional Du Cancer De Montpellier (Hospital/Clinic/Other health care facility). Phase: Therapeutic exploratory (Phase II). Countries: France (ongoing, recruiting).
Therapeutic area(s): Diseases [C] - Neoplasms [C04]
Gender: Female, Male. Age: 18-64 years, 65+ years. Enrolment: 102.
Status: Ongoing, recruiting. Start date (EU): 2024-09-05. Decision date: 2024-09-05. Results received: No. Last updated: 2026-07-07.

Condition(s): Patients with severe and radio-induced breast fibrosis after breast cancer
Product: PRAVASTATIN

Primary endpoint: The primary endpoint is the BRQoL improvement rate at 12 months, compared with baseline, defined as: - An improvement of 5 points (or more) of the score assessed by the functional scale “body image” of the QLQ-BR23 (summary score including the items # 39-42), or - a reduction of 5 points (or more) of the score on the symptom scale “breast symptoms” assessed by the QLQ-BR23 (summary score including the items # 51- 53).
Endpoint(s): Health-related quality of life assessed by the EORTC QLQ-C30 and its module BR23 (at baseline; 12 months, visit of end of treatment with Pravastatin; during the follow-up: month 24, 36, 48 and 60) (see appendix 1 and 2)., Rate and dose of used antidepressants, anxiolytics and analgesics., Psychological distress assessed by the Hospital Anxiety and Depression Scale (at baseline; 12 months, visit of end of treatment with Pravastatin; during the follow-up: month 24, 36, 48 and 60), Timing of the e-PROs alerts and the care management (phone call or planning of a consultation, treatment initiation)., Evolution of the 7 different e-PROs scores across time (scores of general pain, anxiety, sadness, texture of the treated breast, two other symptoms assessed by the PRO-CTCAE scales, and scores of aesthetic impact assesses by a Visual Analog Scale), Number of hospital emergency visits or hospitalizations., Number of supplementary consultations., Regression rate of at least 1 grade of fibrosis (follow-up of fibrosis grade evolution since inclusion)., Relapse-free survival defined as the time from the date of randomization to the date of the first observed oncological event such as local, ipsilateral, regional or metastatic recurrence or death for any cause.

Source: https://euclinicaltrials.eu/ctis-public/view/2024-515342-16-00